EU clinical trial 2024-511346-39-00: Phase IB open label, long-term, extension basket trial of RAY121 to inhibit classical complement pathway in immunological diseases (RAINBOW-LTE trial)
Protocol code: RAY903CT
Sponsor: Chugai Pharmaceutical Co. Ltd. (Pharmaceutical company). Phase: Human Pharmacology (Phase I)- Other. Countries: France (ongoing, recruiting), Czechia (ended), Portugal (authorised, recruitment pending), Netherlands (authorised, recruitment pending), Croatia (authorised, recruitment pending), Hungary (ongoing, recruiting), Italy (authorised, recruitment pending), Poland (ongoing, recruiting), Austria (ended), Romania (ongoing, recruiting), Bulgaria (authorised, recruiting), Norway (ongoing, recruiting), Germany (ongoing, recruiting), Spain (authorised, recruiting).
Therapeutic area(s): Diseases [C] - Skin and Connective Tissue Diseases [C17]
Gender: Female, Male. Age: 18-64 years, 65+ years. Enrolment: 78.
Start date (EU): 2025-03-28. Decision date: 2025-02-11. Results received: No. Last updated: 2026-06-29.
Decision dates by country: AT: 2025-02-17, RO: 2025-02-14, ES: 2025-03-27, IT: 2025-02-12, PL: 2025-02-17, CZ: 2025-02-12, BG: 2025-02-12, HR: 2025-02-25, HU: 2025-02-13, NL: 2025-02-14, DE: 2025-03-19, PT: 2025-02-11, NO: 2025-02-13, FR: 2025-02-12

Condition(s): Behçet’s Syndrome, Immune Thrombocytopenia, Antiphospholipid syndrome, Dermatomyositis, Bullous pemphigoid, Immune-mediated necrotizing myopathy

Source: https://euclinicaltrials.eu/ctis-public/view/2024-511346-39-00